EU clinical trial 2022-502854-16-00: A Phase 2 study to evaluate the efficacy and safety of RPT193 in adults with moderate-to-severe T2-high asthma who are partially controlled on inhaled corticosteroid and long-acting beta 2 agonist therapy
Protocol code: RPT193-03
Sponsor: Rapt Therapeutics Inc. (Pharmaceutical company). Phase: Therapeutic exploratory (Phase II). Countries: Czechia (ended), Bulgaria (ended), Poland (ended).
Therapeutic area(s): Diseases [C] - Respiratory Tract Diseases [C08]
Gender: Female, Male. Age: 18-64 years, 65+ years. Enrolment: 71.
Status: Ended. Start date (EU): 2023-11-26. End date (EU): 2024-06-21. End date: 2024-06-22. Decision date: 2023-10-09. Results received: Yes. Last updated: 2024-02-21.
Decision dates by country: BG: 2023-10-16, CZ: 2023-10-09, PL: 2023-10-16

Condition(s): Asthma
Product: RPT193, Flixotide 50 micrograms Evohaler, Seretide Diskus 50 Mikrogramm/250 Mikrogramm/Dosis, einzeldosiertes Pulver zur Inhalation, Flixotide 250 micrograms Evohaler, Flixotide 125 micrograms Evohaler, Ventolin Evohaler 100 micrograms Pressurised Inhalation Suspension, Tablet without active substance, Seretide Diskus 50 Mikrogramm/100 Mikrogramm/Dosis, einzeldosiertes Pulver zur Inhalation, Seretide Diskus 50 Mikrogramm/500 Mikrogramm/Dosis, einzeldosiertes Pulver zur Inhalation

Primary endpoint: Proportion of subjects who satisfy any of the following LOAC criteria: - ≥30% reduction in morning PEF from baseline on 2 consecutive days - ≥6 additional reliever inhalations of SABA in a 24-hour period relative to abseline on 2 consecutive days - Increase by a factor of 4 or more in the most recent dose of ICS - Exacerbation of asthma requiring systemic CS. - Exacerbation of asthma - related AE that requires a hospitalization or emergency room visit
Endpoint(s): Frequency of treatment-emergent adverse events, Time to a LOAC event, Change in forced expiratory volume in 1 second (FEV1) at Day 99 (Week 14) and at each interval visit after treatment with RPT193 compared to baseline, Change in Questionnaire score at Day 99 (Week 14) and at each interval visit after treatment with RPT193 compared to baseline, Change in PEF at Day 99 (Week 14) and at each interval visit after treatment with RPT193 compared to baseline, Change in reliever bronchodilator use at Day 99 (Week 14) and at each interval visit after treatment with RPT193 compared to baseline, Change in fractional exhaled nitric oxide (FeNO) at Day 99 (Week 14) and at each interval visit after treatment with RPT193 compared to baseline, Change in Questionnaire at Day 99 (Week 14) and at each interval visit after treatment with RPT193 compared to baseline, Change in FEV1 from Day 99 to 140 (Weeks 14 to 20), Change in FEV1 from Day 43 to 98 (Weeks 6 to 14)

Source: https://euclinicaltrials.eu/ctis-public/view/2022-502854-16-00